EU clinical trial 2023-503470-21-00: Efficacy of Remimazolam with Fentanyl versus Midazolam with Fentanyl for sedation in screening colonoscopy: A randomized controlled study
Protocol code: REMI2023
Sponsor: Herlev Hospital (Hospital/Clinic/Other health care facility). Phase: Therapeutic use (Phase IV). Countries: Denmark (ended).
Therapeutic area(s): Analytical, Diagnostic and Therapeutic Techniques and Equipment [E] - Anesthesia and Analgesia [E03]
Gender: Female, Male. Age: 18-64 years, 65+ years. Enrolment: 200.
Status: Ended. Start date (EU): 2023-08-25. End date (EU): 2023-12-23. Decision date: 2023-04-05. Results received: Yes. Last updated: 2023-08-28.

Condition(s): Screening patients
Product: Midazolam hameln 5 mg/ml raztopina za injiciranje/infundiranje, Byfavo 20 mg powder for solution for injection, Fentanyl ”Hameln”

Primary endpoint: Total time from start of medication to fulfillment of the discharge criteria
Endpoint(s): Need for postprocedural recovery room, due to lack of fulfillment of discharge criteria., Patient discomfort/pain rated using NRS-11., Time to reach coecum., Need for additional Fentanyl., Need for additional sedativa., Patient satisfaction., Endoscopist satisfaction, Cognitive function at discharge.

Source: https://euclinicaltrials.eu/ctis-public/view/2023-503470-21-00